EU clinical trial 2023-506616-41-00: A Randomized, Double-blind, Placebo-Controlled Study to Investigate the Efficacy and Safety of Carisbamate (YKP509) as Adjunctive Treatment for Seizures Associated with Lennox-Gastaut Syndrome in Children and Adults, with Optional Open- Label Extension
Protocol code: YKP509C003
Sponsor: Sk Life Science Inc. (Pharmaceutical company). Phase: Therapeutic confirmatory (Phase III). Countries: Spain (ongoing, recruiting), Hungary (ongoing, recruiting), Italy (ongoing, recruiting), Germany (ongoing, recruiting), Poland (ongoing, recruiting), Greece (ended), Portugal (ongoing, recruiting).
Therapeutic area(s): Diseases [C] - Nervous System Diseases [C10]
Gender: Female, Male. Age: 0-17 years, 18-64 years. Enrolment: 92.
Start date (EU): 2023-03-31. Decision date: 2024-06-20. Results received: No. Last updated: 2026-07-23.
Decision dates by country: GR: 2024-07-22, ES: 2024-06-21, DE: 2024-06-26, HU: 2024-06-20, PT: 2024-06-24, PL: 2024-06-24, IT: 2024-06-26

Condition(s): Lennox-Gastaut syndrome (LGS)
Product: Placebo for Carisbamate Oral Suspension, CARISBAMATE

Primary endpoint: The primary outcome will be the percentage change from baseline in the total frequency (average per 28 days) of countable drop seizures with potential to fall (tonic, atonic, tonic-clonic) during the double-blind treatment period.
Endpoint(s): 1. The percentage of subjects with at least a 50% reduction from baseline in the total frequency of countable drop seizures (tonic, atonic, tonic-clonic) during the double-blind treatment period., 2. Percentage change from baseline in the frequency of all types of seizures (total seizures) during the double-blind treatment period., 3. Subject/Caregiver Global Impression of Change in overall condition (S/CGI-C) score at the last visit., Please refer to the Protocol for further Secondary endpoints.

Source: https://euclinicaltrials.eu/ctis-public/view/2023-506616-41-00